EU clinical trial 2025-520624-25-00: A Phase 2/3, Open-label, Single-arm, Multicenter, Historical Control Study to Evaluate ELA026 in Participants with Secondary Hemophagocytic Lymphohistiocytosis (sHLH)
Protocol code: ELA026-CP002
Sponsor: Electra Therapeutics Inc. (Pharmaceutical company). Phase: Phase II and Phase III (Integrated). Countries: Germany (authorised, recruiting), Spain (authorised, recruiting), Italy (authorised, recruiting), Netherlands (authorised, recruiting).
Therapeutic area(s): Diseases [C] - Immune System Diseases [C20]
Gender: Female, Male. Age: 0-17 years, 18-64 years, 65+ years. Enrolment: 40.
Status: Authorised, recruiting. Start date (EU): 2025-09-19. Decision date: 2025-08-05. Results received: No. Last updated: 2026-07-21.
Decision dates by country: ES: 2025-08-07, IT: 2025-08-05, DE: 2025-08-07, NL: 2025-08-06

Condition(s): Secondary Hemophagocytic Lymphohistiocytosis (sHLH)
Product: ELA026

Primary endpoint: 56-day survival from the time of diagnosis
Endpoint(s): 30-day, 45-day, 56-day (any type of cancer), 90-day survival (early survival) from time of diagnosis; Survival status at hospital discharge for initial hospital admission for sHLH; Number of participants achieving HLH disease response by Day 29 (modified HLH-2004 criteria and biomarker criteria)., HLH disease response is defined as a participant who achieves complete response, modified CR, partial response, or HLH improvement; Incidence of treatment-emergent adverse events

Source: https://euclinicaltrials.eu/ctis-public/view/2025-520624-25-00